EU clinical trial 2024-513207-13-00: A randomized phase II trial of Stereotactic Body Radiation Therapy (SBRT) with or without Durvalumab (MEDI4736) in oligometastatic recurrent hormone sensitive prostate cancer patients (POSTCARD - GETUG P13)
Protocol code: POSTCARD - GETUG-P13
Sponsor: Institut De Cancerologie De L Ouest (Hospital/Clinic/Other health care facility). Phase: Therapeutic exploratory (Phase II). Countries: France (ongoing, recruitment ended).
Therapeutic area(s): Diseases [C] - Male Urogenital Diseases [C12]; Diseases [C] - Neoplasms [C04]
Gender: Male. Age: 18-64 years, 65+ years. Enrolment: 96.
Status: Ongoing, recruitment ended. Start date (EU): 2019-03-21. Decision date: 2024-07-05. Results received: No. Last updated: 2024-07-05.

Condition(s): oligometastatic hormone sensitive prostate cancer
Product: IMFINZI 50 mg/mL concentrate for solution for infusion.

Primary endpoint: 3 types of progression are defined and definitions of progression are used and registered according to the recommendations of the prostate cancer clinical trials working group. If a patient meets any of the progression criteria or death from any causes, the patient will be considered to have progressive disease. Calculation will start from randomization until progression or death. 1. PSA or biochemical progression 2. Local progression 3. Distant progression
Endpoint(s): a) Time from randomization to the date of PSA or biochemical progression as defined above, b) Time from randomization to the date of any event of PSA progression, local progression, distant progression, or death, c) Time from randomization to the date of any event of local progression, distant progression, or death, d) Time from randomization to the date of any event of distant progression, or death, e)Quality of life scoring using the EORTC QLQ-C30 supplemented with QLQ-PR25 and pain with BPI + EVA, f) ADT will be started in both arms at time of polymetastatic disease, local progression of metastases (defined above) or symptoms. In case of a metachronous oligometastatic recurrence, a retreatment with radiotherapy or surgery is allowed. Calculation will start from randomization until ADT is started., g) Prostate cancer specific survival (PCSS) will be calculated from randomization until Prostate cancer death or complications related to the protocol treatment, h) Overall survival (OS) will be calculated from randomization until death from any cause, Time to first symptomatic event will be calculated from randomization until the event of symptoms due to metastatic disease, j) Acute and late toxicity due to radiotherapy will be scored using the Common toxicity criteria version 5.0, k) Plasma biomarkers measurements, l) Immune response monitoring, m) PDL1 expression in CTCs, n) Time to castration resistance, o) Association between the PSA 3, 5, and 7-months after SBRT (in 3 classes : <0.1 ng/mL / 0.1-0.49 / >0.5 ng/mL), and dPFS, PCSS and OS (ref : PMID: 29727915, PMID: 24739897). Exploratory analyses investigating association between other PSA threshold values at different timepoints with survival outcomes will be performed, NED is defined as patients meeting all of the following: - Alive - No biochemical recurrence (defined as PSA >0.5 ng/ml + nadir and rising) - No distant progression - No local progression - No subsequent therapy for PC

Source: https://euclinicaltrials.eu/ctis-public/view/2024-513207-13-00